EU clinical trial 2026-525682-45-00: Efficacy of oral bicarbonate versus placebo on the risk of assisted delivery in nulliparous women with prolonged labour (ProLabour): protocol fora randomized controlled trial
Sponsor: Region Hovedstaden (Hospital/Clinic/Other health care facility). Phase: Therapeutic use (Phase IV). Countries: Denmark (authorised, recruitment pending).
Therapeutic area(s): Diseases [C] - Female Urogenital Diseases and Pregnancy Complications [C13]
Gender: Female. Age: 18-64 years. Enrolment: 1520.
Status: Authorised, recruitment pending. Decision date: 2026-07-14. Results received: No. Last updated: 2026-07-14.

Condition(s): Prolonged labour
Product: The placebo contains only inert excipients (glucose 3 g, sodium chloride 0,65 g, silica 0,05 g) and a flavouring agent (aroma, lemon–peach, food-grade excipient)., Samarin

Primary endpoint: The primary endpoint is the incidence of assisted delivery, defined as a composite of emergency caesarean section or instrumental vaginal delivery.
Endpoint(s): Admission of the child to the neonatal intensive care unit within 24 hours after birth. Birth experience (The Childbirth Experience Questionnaire).

Source: https://euclinicaltrials.eu/ctis-public/view/2026-525682-45-00